EU clinical trial 2023-506307-26-00: A Single-Arm, Open-Label, Multicenter, Phase 1b/2 Study Evaluating the Safety and Efficacy of AUTO1 (obecabtagene autoleucel [obe-cel]) in Pediatric Patients with CD19-positive Relapsed/Refractory (R/R) B cell Acute Lymphoblastic Leukemia (B ALL) or R/R Aggressive Mature B Cell Non–Hodgkin Lymphoma (B NHL)
Protocol code: AUTO1-PY1
Sponsor: Autolus Limited (Pharmaceutical company). Phase: Human Pharmacology (Phase I)- Other. Countries: Spain (ongoing, recruiting).
Therapeutic area(s): Diseases [C] - Neoplasms [C04]
Gender: Female, Male. Age: 0-17 years. Enrolment: 14.
Status: Ongoing, recruiting. Start date (EU): 2024-05-22. Decision date: 2023-09-15. Results received: No. Last updated: 2026-06-08.

Condition(s): B-cell Acute Lymphoblastic Leukemia (B ALL) and Aggressive Mature B-cell Non-Hodgkin Lymphoma (B NHL).
Product: Cyclophosphamide 500 mg Powder for Solution for Injection or Infusion, AUTO1, Fludara 50 mg powder for solution for injection or infusion.

Primary endpoint: B ALL Cohort: Proportion of pediatric participants with r/r B ALL at screening who achieve CR within 3 months of obe-cel infusion per IRRC assessment, B ALL Cohort: Proportion of pediatric participants with r/r B ALL at screening who achieve ORR (CR + CRi) within 3 months of obe-cel infusion per IRRC assessment, B ALL and B NHL Cohorts: Frequency and severity of adverse events (AEs) and serious adverse events (SAEs) after receiving obe-cel infusion, B ALL and B NHL Cohorts: Incidence and duration of severe hypogammaglobulinemia
Endpoint(s): B-ALL Cohort (Key Secondary): Proportion of pediatric participants with r/r B ALL with successful ClonoSEQ® NGS MRD calibration who achieve MRD-negative ORR below the 10-4 level (< 0.01%) within 3 months of obe-cel infusion per IRRC assessment, B-NHL Cohort (Secondary): • ORR (CR + PR) • Duration of response (DoR); • Progression free survival (PFS); • Overall survival (OS); • Incidence of CD19-negative relapse., B ALL Cohort (Secondary): • CR at any time • ORR (CR + CRi) at any time • MRD-negative ORR below the 10-4 level (< 0.01%) at any time • Duration of Remission (DoR) • Event Free Survival (EFS) • Overall Survival (OS) • Proportion of participants undergoing HSCT while still in CR/CRi following obe-cel • Incidence of CD19-negative relapse at any time

Source: https://euclinicaltrials.eu/ctis-public/view/2023-506307-26-00